EU clinical trial 2024-516921-29-00: A study to test how well different doses of BI 3031185 are tolerated by healthy men and women
Protocol code: 1516-0002
Sponsor: Boehringer Ingelheim International GmbH (Pharmaceutical company). Phase: Human Pharmacology (Phase I)- Other. Countries: Germany (ongoing, recruiting).
Therapeutic area(s): Not possible to specify
Gender: Female, Male. Age: 18-64 years. Enrolment: 60.
Status: Ongoing, recruiting. Start date (EU): 2025-03-25. Decision date: 2025-01-30. Results received: No. Last updated: 2026-06-09.

Condition(s): Healthy volunteer trial

Source: https://euclinicaltrials.eu/ctis-public/view/2024-516921-29-00